EU clinical trial 2023-508769-33-00: Protocol with Progestin-primed Ovarian Stimulation (PPOS) in conventional treatment from the start of stimulation vs protocol with GnRH antagonists as a pituitary suppressor in patients who are going to undergo DUOSTIM with embryo accumulation for PGT-A of the embryos.
Sponsor: Ginefiv S.L. (Hospital/Clinic/Other health care facility). Phase: Therapeutic use (Phase IV). Countries: Spain (ongoing, recruiting).
Therapeutic area(s): Diseases [C] - Female Urogenital Diseases and Pregnancy Complications [C13]
Gender: Female. Age: 18-64 years. Enrolment: 144.
Status: Ongoing, recruiting. Start date (EU): 2024-12-05. Decision date: 2024-03-11. Results received: No. Last updated: 2026-05-25.

Condition(s): Female infertility
Product: Progevera 10 mg comprimidos, GANIRELIX

Primary endpoint: number of euploid embryos

Source: https://euclinicaltrials.eu/ctis-public/view/2023-508769-33-00